EU clinical trial 2025-522147-18-00: A clinical trial of MK-7228 in adults (MK-7228-002)
Protocol code: MK-7228-002
Sponsor: Merck Sharp & Dohme LLC (Pharmaceutical company). Phase: Human Pharmacology (Phase I)- Other. Countries: Belgium (ongoing, recruitment ended).
Therapeutic area(s): Diseases [C] - Cardiovascular Diseases [C14]
Gender: Female, Male. Age: 18-64 years. Enrolment: 40.
Status: Ongoing, recruitment ended. Start date (EU): 2026-03-30. Decision date: 2026-03-17. Results received: No. Last updated: 2026-03-17.

Condition(s): Atherosclerosis

Source: https://euclinicaltrials.eu/ctis-public/view/2025-522147-18-00